EU clinical trial 2023-503486-32-00: Efficacy of autologous bone marrow-derived mesenchymal stem cells seeded on a 3D scaffold in treatment of knee cartilage defects. A randomized, controlled, open-label, multi-centre clinical trial.
Protocol code: OA-orMSCp-01
Sponsor: Bioinova a.s. (Pharmaceutical company). Phase: Therapeutic exploratory (Phase II). Countries: Czechia (ongoing, recruiting).
Therapeutic area(s): Diseases [C] - Skin and Connective Tissue Diseases [C17]
Gender: Female, Male. Age: 18-64 years. Enrolment: 40.
Status: Ongoing, recruiting. Start date (EU): 2021-02-04. Decision date: 2024-11-15. Results received: No. Last updated: 2025-05-10.

Condition(s): Knee Cartilage Defect
Product: BiCure ortho MSCp

Primary endpoint: Lysholm knee function score, at 24 months post-operation (comparison of score changes between the study arms)., KOOS value, at 24 months post-operation (comparison of score changes between the study arms)., Pain according to VAS, at 24 months post-operation (comparison of score changes between the study arms)., X-ray and MRI evaluation, at 24 months post-operation.
Endpoint(s): Lysholm knee function score, at 3, 6 and 12 months post-operation., KOOS value, at 3 , 6 and 12 months post-operation., Pain according to VAS, at 6 weeks, 3, 6 and 12 months post-operation., X-ray and MRI evaluation, at 12 months post-operation., Adverse event profiles at 6 weeks, 3, 6, 12 and 24 months post-operation (comparison between the study arms).

Source: https://euclinicaltrials.eu/ctis-public/view/2023-503486-32-00